EU clinical trial 2024-513560-26-00: A phase 2, multicenter, randomized, double-blind, placebo-controlled study to assess the effect and safety of 400 mg twice a day oral ladarixin in patients with recent onset type 1 diabetes and a low residual β-cell function at baseline.
Protocol code: LDX0319
Sponsor: Dompe' Farmaceutici S.p.A. (Pharmaceutical company). Phase: Therapeutic exploratory (Phase II). Countries: Belgium (ended), Germany (ended), Italy (ended).
Therapeutic area(s): Diseases [C] - Nutritional and Metabolic Diseases [C18]
Gender: Female, Male. Age: 0-17 years, 18-64 years. Enrolment: 103.
Status: Ended. Start date (EU): 2020-12-10. End date (EU): 2025-10-21. End date: 2025-10-22. Decision date: 2024-09-09. Results received: Yes. Last updated: 2024-12-20.
Decision dates by country: BE: 2024-09-09, DE: 2024-09-11, IT: 2024-09-18

Condition(s): Recent onset Type 1 Diabetes
Product: Ladarixin, Placebo to match Ladarixin

Primary endpoint: - Change from baseline in 2-hour AUC of C-peptide response to the MMTT [Primary endpoint. Time frame: Month 6].
Endpoint(s): Change from baseline in 2-hour AUC of C-peptide response to the MMTT [Time frame: month 12, 18 and 24]., Change in HbA1c from baseline [Time frame: Month 6, 12, 18 and 24]., Time in range (TIR) by Continuous Glucose Monitoring (CGM) [Time frame: Month 6, 12, 18, 24]., Proportion of patients with HbA1c <7% who did not experience severe hypoglycemic events during treatment [Time frame: Month 6, 12, 18 and 24]., Average (previous 3 days) daily insulin requirement (IU/kg/day) [Time frame: Month 6, 12, 18 and 24]., Proportion of patients with HbA1c <7% and daily insulin requirement <0.5 (IU/kg/day) [Time frame: Month 6, 12, 18 and 24]., Additional Glucose Variability Indices derived from CGM (glucose AUC outside the target range of 70 – 180 mg/dL, 2-hour postprandial glucose (PPG), Mean Amplitude Glycemic Excursions (MAGE), continuous overall net glycemic action (CONGA)-n, Mean Of the Daily Differences (MODD), and mean daily blood glucose, SD (Standard Deviation). [Time frame: Month 6, 12, 18 and 24]., Number of self-reported episodes of severe hypoglycemia [Time frame: Month 6, 12, 18 and 24]., Percentage of patients not requiring insulin therapy [Time frame: Month 6, 12, 18 and 24], Estimated Glucose Disposal Rate (eGDR) [Time frame: Month 6, 12, 18 and 24].

Source: https://euclinicaltrials.eu/ctis-public/view/2024-513560-26-00